EU clinical trial 2024-515533-15-00: Randomized Phase II Trial Assessing the Inhibitor of Programmed Cell Death Ligand 1 (PD-L1) Immune Checkpoint Atezolizumab in Locally Advanced Cervical Cancer (AtezoLACC)
Protocol code: CSET N°2017/2608
Sponsor: Institut Gustave Roussy (Hospital/Clinic/Other health care facility). Phase: Therapeutic exploratory (Phase II). Countries: France (ended).
Therapeutic area(s): Diseases [C] - Neoplasms [C04]
Gender: Female. Age: 18-64 years, 65+ years. Enrolment: 189.
Status: Ended. End date (EU): 2025-05-13. Decision date: 2024-10-29. Results received: No. Last updated: 2024-10-29.

Condition(s): Locally advanced cervical cancer
Product: Tecentriq 1 200 mg concentrate for solution for infusion

Primary endpoint: The primary endpoint is progression free survival (PFS), defined as the time from randomization to the first documented occurrence of disease progression, as determined by the investigator using RECIST v1.1, or death from any cause, whichever occurs first. Data for patients without disease progression or death will be censored at the date of the last follow-up.
Endpoint(s): Overall survival (OS), defined as the time from randomisation to death due to any cause., Complete response rate at 8 weeks, defined as the percentage of patients with measurable disease at baseline, who have achieved complete response (CR) after treatment initiation, as determined by the investigator using RECIST v1.1 criteria., Locoregional control, defined as the cumulative rate of locoregional recurrence or progression with censoring of deaths without locoregional recurrence or progression., Distant tumour control: defined as the cumulative rate of (distant) metastatic events with censoring of deaths without metastatic progression. In case locoregional recurrence (or progression) and distant progression occur at the same time, the event will be counted as a distant event., Toxicity, defined as any adverse drug reaction (AE assessed at least possibly related to any study treatment) that occurs within 6 months following brachytherapy (acute toxicity) or more than 6 months following brachytherapy (late toxicity). Toxicities will be graded using the National Cancer Institute Common Terminology Criteria for Adverse Events Version 4.03 (NCI CTC-AE v4.03) at each visit.

Source: https://euclinicaltrials.eu/ctis-public/view/2024-515533-15-00